EU clinical trial 2023-507333-17-00: A Phase 3, Randomized, Multi-center, Open-label Study of DB-1303 Versus Investigator’s Choice Chemotherapy in Human Epidermal Growth Factor Receptor 2 (HER2)-low, Hormone Receptor Positive (HR+) Metastatic Breast Cancer Patients whose Disease has Progressed on Endocrine Therapy (ET) (DYNASTY-Breast02)
Protocol code: DB-1303-O-3002
Sponsor: Dualitybio Inc. (Pharmaceutical company). Phase: Therapeutic confirmatory (Phase III). Countries: Poland (ended), Spain (ongoing, recruitment ended), Germany (ongoing, recruitment ended), Hungary (ended), Belgium (ongoing, recruitment ended), Italy (ongoing, recruitment ended), France (ongoing, recruitment ended).
Therapeutic area(s): Diseases [C] - Neoplasms [C04]
Gender: Female, Male. Age: 18-64 years, 65+ years. Enrolment: 77.
Start date (EU): 2024-04-15. Decision date: 2024-03-11. Results received: No. Last updated: 2026-06-05.
Decision dates by country: DE: 2024-03-13, IT: 2024-05-20, PL: 2024-03-12, BE: 2024-05-17, HU: 2024-03-12, FR: 2024-03-11, ES: 2024-03-11

Condition(s): HER2-low, Hormone Receptor Positive, Metastatic Breast Cancer, HER2-low, Hormone Receptor Positive, Metastatic Breast Cancer
Product: CAPECITABINE, PACLITAXEL ALBUMIN-BOUND, PACLITAXEL ALBUMIN-BOUND, PACLITAXEL, DB-1303, CAPECITABINE, CAPECITABINE, PACLITAXEL, CAPECITABINE

Primary endpoint: PFS by BICR according to response evaluation criteria in solid tumors (RECIST) 1.1 in the HR+, HER2-low population
Endpoint(s): OS in the HR+, HER2-low population, ORR and DoR by BICR and Investigator assessment according to RECIST 1.1 in the HR+, HER2-low population, PFS by Investigator assessment according to RECIST 1.1 in the HR+, HER2-low population, TEAEs and SAEs per National Cancer Institute (NCI) Common Terminology Criteria for Adverse Events (CTCAE) v5.0, physical examinations, changes from baseline in laboratory findings, electrocardiograms (ECGs), ECHO/MUGA and vital signs., The patient reported outcomes (PROs) include: change from baseline in EORTC QLQC30 and EORTC QLQ-BR45 Scale scores, time to deterioration in EORTC QLQ-C30 scores, EQ-5D-5L health state utility index

Source: https://euclinicaltrials.eu/ctis-public/view/2023-507333-17-00